EU clinical trial 2024-514728-17-00: A Phase IIIB study to evaluate the use of durvalumab in combination with platinum-based chemotherapy followed by durvalumab with olaparib as first-line treatment in Patients with Newly Diagnosed pMMR Advanced or Recurrent Endometrial Cancer in Spain. DUoENDE Study
Protocol code: D9311L00001
Sponsor: Astrazeneca Farmaceutica Spain S.A. (Pharmaceutical company). Phase: Phase III and phase IV (Integrated). Countries: Spain (ongoing, recruitment ended).
Therapeutic area(s): Diseases [C] - Neoplasms [C04]
Gender: Female. Age: 18-64 years, 65+ years. Enrolment: 45.
Status: Ongoing, recruitment ended. Start date (EU): 2024-12-30. Decision date: 2024-11-04. Results received: No. Last updated: 2026-07-29.

Condition(s): Advanced or recurrent endometrial cancer
Product: Lynparza 150 mg film-coated tablets, Lynparza 100 mg film-coated tablets, IMFINZI 50 mg/mL concentrate for solution for infusion

Primary endpoint: Frequency of AEs that lead to treatment dose changes, temporary interruptions, or permanent discontinuation, Frequency of Immune-mediated adverse events1 (imAEs)., Frequency of grade ≥3 AEs. [Timeframe: 12 months after LSI]
Endpoint(s): Progression Free Survival (PFS) defined as the time from the date of first dose of treatment2 until the date of objective disease progression or death (by any cause in the absence of progression). The measure of interest is the median PFS., Objective Response Rate (ORR) using site investigator assessments according to RECIST 1.1.

Source: https://euclinicaltrials.eu/ctis-public/view/2024-514728-17-00